EU clinical trial 2025-523137-25-00: Single-center, single-dose, open-label, laboratory-blinded, randomized, two-treatment, two-period bioequivalence (BE) study comparing the Test Product Apixaban 5 mg film-coated tablets (MEDITOP) with the Reference Product Eliquis 5 mg film-coated tablets (Bristol-Myers Squibb/Pfizer) under fasting conditions.
Protocol code: MEDITOP/2025/01
Sponsor: MEDITOP Gyogyszeripari Kft. (Pharmaceutical company). Phase: Human Pharmacology (Phase I)- Bioequivalence Study. Countries: Czechia (ended).
Therapeutic area(s): Diseases [C] - Cardiovascular Diseases [C14]
Gender: Female, Male. Age: 18-64 years. Enrolment: 36.
Status: Ended. Start date (EU): 2025-11-03. End date (EU): 2025-11-25. Decision date: 2025-09-10. Results received: No. Last updated: 2025-09-10.

Condition(s): Comparative bioequivalence study in healthy volunteers under fasting conditions.

Source: https://euclinicaltrials.eu/ctis-public/view/2025-523137-25-00